EU clinical trial 2024-519350-37-00: COMPRENDO - A PHASE II OPEN LABEL STUDY FOR THE COMPREHENSIVE ANALYSIS OF PREDICTORS OF THE TREATMENT WITH PEMBROLIZUMAB AND OLAPARIB IN PATIENTS WITH UNRESECTABLE OR METASTATIC HER2 NEGATIVE BREAST CANCER AND A DELETERIOUS GERMLINE MUTATION IN BRCA1/2, ATM, BARD1, CHEK2, FANCC, PALB2, RAD51C, RAD51D, SLX4, XRCC2 OR A HOMOLOGOUS RECOMBINATION DEFICIENCY
Protocol code: IFG-05-2019
Sponsor: Institut fuer Frauengesundheit GmbH (Hospital/Clinic/Other health care facility). Phase: Therapeutic exploratory (Phase II). Countries: Germany (ended).
Therapeutic area(s): Diseases [C] - Neoplasms [C04]
Gender: Female, Male. Age: 18-64 years, 65+ years. Enrolment: 89.
Status: Ended. End date (EU): 2025-01-09. Decision date: 2024-11-28. Results received: Yes. Last updated: 2024-11-28.

Condition(s): patients with unresectable or metastatic HER2 negative breast cancer and a deleterious germline mutation in BRCA 1/2, ATM, BARD1, CHEK2, FANCC, PALB2, RAD51C, RAD51D, SLX4, XRCC2 or a homologous recombination deficiency
Product: PEMBROLIZUMAB, OLAPARIB, OLAPARIB

Primary endpoint: Overall Response confirmed complete response (CR) or partial response (PR) per RECIST v1.1 criteria (time frame: baseline to 27 weeks).
Endpoint(s): duration of response (DOR) defined as the time between the date of first response (CR or PR) to the date of first tumor progression, progression free survival (PFS) defined as the time between the date of study entry and the first date of progression or death, overall survival (OS) defined as the time between the date of study entry and the date of death due to any cause, incidence of adverse events, serious adverse events, fatal events

Source: https://euclinicaltrials.eu/ctis-public/view/2024-519350-37-00